EU clinical trial 2023-507519-36-00: Randomized clinical trial to compare oral isotretinoin to standard of care in moderate acne skin of color patients
Sponsor: Centre Hospitalier Universitaire De Nice (Hospital/Clinic/Other health care facility). Phase: Therapeutic confirmatory (Phase III). Countries: France (ongoing, recruiting).
Therapeutic area(s): Diseases [C] - Skin and Connective Tissue Diseases [C17]
Gender: Female, Male. Age: 0-17 years, 18-64 years. Enrolment: 420.
Status: Ongoing, recruiting. Start date (EU): 2025-04-29. Decision date: 2024-03-12. Results received: No. Last updated: 2026-06-01.

Condition(s): Acne
Product: ADAPALENE ZENTIVA 0,1 %, crème, PROCUTA 20 mg, capsule molle, Doxycycline EG 100 mg, comprimés, EFFEDERM 0,05 %, crème, PROCUTA 40 mg, capsule molle, PROCUTA 10 mg, capsule molle, DIFFERINE 0,1 %, crème, LYMECYCLINE ARROW 408 mg (équivalent à 300 mg de tétracycline base), gélule

Primary endpoint: ARP severity score assessed by dedicated algorithm on facial pictures (selfies) at M6. This algorithm, developed to assess face skin aging hyperpigmented lesions is validated in ARP in dark skin types. The score ranges from 0 (no ARP) to 4 (severe ARP). A success is a patient with a score < 2 at M6 (ARP score<2 shows no or very mild ARP).
Endpoint(s): Efficacity in subgroups will be evaluated as in main criteria at M6. The two subgroups will be patients with no or mild ARP at the inclusion (ARP score assessed by the algorithm on selfie <2) and the patients with already moderate to severe ARP (ARP score > or =2) at the inclusion., The inflammatory and retentional lesions count will be assessed by dedicated algorithm on facial pictures (selfies) at 3 months and at 6 months. We will consider their evolution at M3 and M6 compared to baseline. Also, the evolution of inflammatory and retentional lesions will be assessed clinically by using the GEA scale grading., Number, grade and severity of adverse events in the two groups wil be presented. A special focus on scars will be performed using an IGA score (0 no scar, 1 mild scarring, 2 moderate, 3 severe) over the study period. For adolescent, ADRS (Adolescent Depression Rating Scale) will be additionally performed at each visit., Quality of life will be evaluated with the Acne-specific Quality of Life questionnaire (Acne-QoL)

Source: https://euclinicaltrials.eu/ctis-public/view/2023-507519-36-00